EU clinical trial 2024-514724-16-01: A phase 2A pilot study to assess the safety and efficacy of eltanexor in relapsed/refractory NPM1-mutated acute myeloid leukemia
Protocol code: ELENA-01
Sponsor: Azienda Ospedaliero Universitaria Delle Marche (Hospital/Clinic/Other health care facility). Phase: Therapeutic exploratory (Phase II). Countries: Italy (ongoing, recruiting).
Therapeutic area(s): Diseases [C] - Hemic and Lymphatic Diseases [C15]; Diseases [C] - Neoplasms [C04]
Gender: Female, Male. Age: 18-64 years, 65+ years. Enrolment: 10.
Status: Ongoing, recruiting. Start date (EU): 2025-01-14. Decision date: 2025-01-13. Results received: No. Last updated: 2026-04-13.

Condition(s): Acute Myeloid Leukemia
Product: Eltanexor

Primary endpoint: Response rate (sum of CR, CRi, MLFS) by the end of cycle 2, Rate of Grade 5, non-hematological Grade 4 and long-lasting non-hematological Grade 3 adverse events

Source: https://euclinicaltrials.eu/ctis-public/view/2024-514724-16-01